EU clinical trial 2023-508754-26-00: A Phase 2, Open-Label, Extension Study to Evaluate the Long-Term Safety, Tolerability, and Efficacy of BMN 111 in Children with Achondroplasia
Protocol code: 111-205
Sponsor: Biomarin Pharmaceutical Inc. (Pharmaceutical company). Phase: Therapeutic exploratory (Phase II). Countries: France (ended).
Therapeutic area(s): Phenomena and Processes [G] - Musculoskeletal and Neural Physiological Phenomena [G11]
Gender: Female, Male. Age: 0-17 years. Enrolment: 1.
Status: Ended. Start date (EU): 2017-02-10. End date (EU): 2024-12-19. Decision date: 2024-05-28. Results received: No. Last updated: 2024-09-30.

Condition(s): Achondroplasia
Product: Voxzogo 0.56 mg powder and solvent for solution for injection, Voxzogo 1.2 mg powder and solvent for solution for injection

Primary endpoint: Safety will be evaluated by the incidence of AEs, serious adverse events (SAEs), laboratory test results (urinalysis, chemistry, hematology), changes in vital signs, physical examination, and echocardiogram (ECHO), X-rays/QCT results, and clinical hip assessment.
Endpoint(s): Efficacy will be assessed by change from baseline in height growth velocity (annualized to cm/year), height, final adult height, growth parameters, and in body proportions. These changes will be assessed by anthropometric measurements and measurement ratios. Growth parameters (anthropometric measurements) may include but are not limited to height, standing height, sitting height, weight, head circumference, upper and lower arm and leg length, and arm span., Body proportion measurements may include but are not limited to upper: lower body segment ratio, upper arm: forearm length ratio, upper leg: lower leg length ratio, and arm span: standing height ratio. Final adult height defined as the height achieved at 16 years of age for females, and 18 years of age for males.

Source: https://euclinicaltrials.eu/ctis-public/view/2023-508754-26-00